EU clinical trial 2025-524463-20-00: The MODIFY Study: A Phase 3b/4 randomized, double-blind, placebo-controlled, multicentre study evaluating the impact of early intervention with depemokimab on exacerbation rate, clinical remission, lung function decline, and safety in adults and adolescents with at risk Type 2 asthma, conducted up to 156 weeks.
Protocol code: 222926
Sponsor: Glaxosmithkline Research & Development Limited (Pharmaceutical company). Phase: Therapeutic confirmatory (Phase III). Countries: Ireland (authorised, recruitment pending), Spain (authorised, recruitment pending), Germany (authorised, recruitment pending), Czechia (authorised, recruitment pending), Bulgaria (authorised, recruitment pending), France (authorised, recruitment pending), Belgium (authorised, recruitment pending), Romania (ongoing, recruiting), Italy (authorised, recruitment pending).
Therapeutic area(s): Diseases [C] - Respiratory Tract Diseases [C08]
Gender: Female, Male. Age: 0-17 years, 18-64 years, 65+ years. Enrolment: 229.
Start date (EU): 2026-07-31. Decision date: 2026-07-14. Results received: No. Last updated: 2026-07-20.
Decision dates by country: BE: 2026-07-14, BG: 2026-07-20, CZ: 2026-07-15, FR: 2026-07-20, DE: 2026-07-17, IE: 2026-07-17, IT: 2026-07-16, RO: 2026-07-20, ES: 2026-07-17

Condition(s): Asthma
Product: EXDENSUR 100 mg solution for injection in pre-filled syringe, Sterile 0.9% (w/v) sodium chloride solution in single-use PFS.

Primary endpoint: 1. Annualized rate of clinically significant exacerbations over the treatment period.
Endpoint(s): 1. Clinical remission at 2 years (104 weeks), defined as: • No clinically significant asthma exacerbations during the first 2 years of the treatment period and • No maintenance OCS for asthma at 2 years and • Well controlled asthma based on an ACT ≥20 at 2 years and • No deterioration of lung function. Deterioration is defined as a reduction in post-BD FEV1 of more than 0 ml at 2 years compared to baseline., 2. Change from baseline in AQLQ total overall score at 2 years, in participants with baseline ACQ-5 ≥1.5., 3. Change from baseline in ACQ-5 score at 2 years, in participants with baseline ACQ-5 ≥1.5., 4. Change from baseline of post-BD FEV1 at 2 years., 5. Change from baseline of pre-BD FEV1 at 2 years.

Source: https://euclinicaltrials.eu/ctis-public/view/2025-524463-20-00